EU clinical trial 2024-517384-24-00: INNOVATIVE TREATMENT OF SCARRED VOCAL FOLDS BY LOCAL INJECTION OF AUTOLOGOUS ADIPOSE-DERIVED STROMAL VASCULAR FRACTION: EFFICACY VERSUS PLACEBO
Protocol code: cellcordes2
Sponsor: Centre Hospitalier Regional De Marseille (Hospital/Clinic/Other health care facility). Phase: Therapeutic exploratory (Phase II). Countries: France (ongoing, recruiting).
Therapeutic area(s): Diseases [C] - Otorhinolaryngologic Diseases [C09]
Gender: Female, Male. Age: 18-64 years, 65+ years. Enrolment: 36.
Status: Ongoing, recruiting. Start date (EU): 2022-09-22. Decision date: 2024-09-30. Results received: No. Last updated: 2026-03-12.

Condition(s): SCARRED VOCAL FOLDS
Product: Placebo SVF inj prep, SVF 5 inj prep, thawed SVF 5 inj prep

Primary endpoint: Changes from baseline in Self-evaluation with the Voice Handicap Index (VHI), a shift in the total score of 18 points or greater being required to be clinically significant (Jacobson, 1997)
Endpoint(s): VHI at 1 month, self-evaluation of dysphonia (0-10 scale), voice acoustic measurements, voice aerodynamic measurements: maximum phonation time, perceptive analysis (GRB scale): score will be calculated by addition of two characteristics, videolaryngostroboscopy, The incidence of related Adverse Events

Source: https://euclinicaltrials.eu/ctis-public/view/2024-517384-24-00